EU clinical trial 2023-506735-15-00: MT-7117-A-302 Study: A Phase 3, Multicenter, Randomized, Double-Blind, Placebo-Controlled Study to Evaluate Efficacy, Safety, and Tolerability of MT-7117 in Adults and Adolescents with Erythropoietic Protoporphyria or X-Linked Protoporphyria
Protocol code: MT-7117-A-302
Sponsor: Tanabe Pharma America Inc. (Pharmaceutical company). Phase: Therapeutic confirmatory (Phase III). Countries: Spain (ended), Bulgaria (ended), Netherlands (ended), France (ended), Czechia (ended), Poland (ended), Italy (ended).
Therapeutic area(s): Diseases [C] - Skin and Connective Tissue Diseases [C17]
Gender: Female, Male. Age: 0-17 years, 18-64 years, 65+ years. Enrolment: 98.
Status: Ended. Start date (EU): 2024-04-05. End date (EU): 2026-05-19. End date: 2026-05-20. Decision date: 2024-03-11. Results received: No. Last updated: 2026-04-29.
Decision dates by country: CZ: 2024-03-11, FR: 2024-04-19, ES: 2024-03-19, PL: 2024-06-18, NL: 2024-03-25, BG: 2024-03-20, IT: 2024-03-11

Condition(s): Erythropoietic Protoporphyria or X-Linked Protoporphyria
Product: MT-7117 Formulation Code C, MT-7117 Placebo

Primary endpoint: Change from baseline in average daily sunlight exposure time (in minutes) to first prodromal symptom (burning, tingling, itching, or stinging) associated with sunlight exposure between 1-hour post-sunrise and 1 hour pre-sunset at Week 16.
Endpoint(s): Patient Global Impression of Change (PGIC) at Week 16., Total number of sunlight-induced pain events defined as prodromal symptoms (burning, tingling, itching, or stinging) with pain rating of 1-10 on the Likert scale during the 16-week double-blind treatment period., Total number of sunlight-induced non-prodrome, phototoxic reactions during the 16-week double-blind treatment period.

Source: https://euclinicaltrials.eu/ctis-public/view/2023-506735-15-00